EU clinical trial 2024-515225-28-00: TOTAL NEOADJUVANT TREATMENT WITHOUT SURGERY FOR LOCALLY ADVANCED RECTAL CANCER: PROSPECTIVE CLINICAL TRIAL TO ASSESS TUMOR COMPLETE RESPONSE, CIRCULATING TUMOR GENETIC AND EPIGENETIC BIOMARKERS, AND STROMAL TRANSCRIPTOME TO INTERPRET CLINICAL OUTCOME (NO-CUT TRIAL)
Protocol code: NO-CUT TRIAL
Sponsor: ASST Grande Ospedale Metropolitano Niguarda (Hospital/Clinic/Other health care facility). Phase: Phase II and Phase III (Integrated). Countries: Italy (authorised, recruitment pending).
Therapeutic area(s): Diseases [C] - Neoplasms [C04]
Gender: Female, Male. Age: 18-64 years, 65+ years. Enrolment: 180.
Status: Authorised, recruitment pending. Decision date: 2024-08-05. Results received: No. Last updated: 2024-08-05.

Condition(s): Adenocarcinoma of the medium/lower rectum in Stage II (cT3-4 N0) or Stage III (cT1-4, N1-2)
Product: OXALIPLATIN, CAPECITABINE

Primary endpoint: - Distant Relapse-Free Survival (DRFS) rate at 2.5 year - Association between 6-methylated gene panel and hazard ratio (HR) for relapse free survival - Association between ctDNA and relative hazard per standard deviation unit (HRσ) - Association between stromal score and odds ratio of response to treatment
Endpoint(s): - Clinical complete response rate - Local recurrence and organ preservation rate, colostomy-free survival - Overall survival - Patient reported outcomes (European Organization for Research and Treatment of Cancer [EORTC] QLQ-C30 and its colorectal cancer specific module QLQ-38)

Source: https://euclinicaltrials.eu/ctis-public/view/2024-515225-28-00